EU clinical trial 2024-519078-38-00: EvaluaTion of Clinical and laboratory outcomes of Rivaroxaban in short Bowel syndrome patients dEpending on Long term parenteral nutrition: a prospective cohort study (TINCRBEL study)
Sponsor: Amsterdam UMC Stichting (Patient organisation/association). Phase: Therapeutic use (Phase IV). Countries: Netherlands (authorised, recruiting).
Therapeutic area(s): Diseases [C] - Cardiovascular Diseases [C14]
Gender: Female, Male. Age: 18-64 years, 65+ years. Enrolment: 24.
Status: Authorised, recruiting. Start date (EU): 2024-11-22. Decision date: 2024-11-22. Results received: No. Last updated: 2024-11-22.

Condition(s): short bowel syndrome
Product: Xarelto 20 mg film-coated tablets

Primary endpoint: i. Main study parameter/endpoint Clinical outcomes after one year, related to the laboratory levels per subject: * Efficacy: venous thromboembolism, cerebrovascular stroke * Safety: (major) bleeding cfr. ISTH criteria, mortality ii. Secondary study parameters/endpoints * Inter- and intraindividual variability of rivaroxaban absorption Laboratory outcomes: * Correlation between anti Xa levels and rivaroxaban plasma concetrations as assessed by LC-MS/MS Quality of life assessment * SF-36
Endpoint(s): iii. Other study parameters Baseline characteristics will be collected; * Age * Sex

Source: https://euclinicaltrials.eu/ctis-public/view/2024-519078-38-00